EU clinical trial 2023-510301-18-00: A Phase 2 Study of Erdafitinib in Subjects with Advanced Solid Tumors and FGFR Gene Alterations
Protocol code: 42756493CAN2002
Sponsor: Janssen Cilag International (Pharmaceutical company). Phase: Therapeutic exploratory (Phase II). Countries: Germany (ended), Spain (ended).
Therapeutic area(s): Diseases [C] - Neoplasms [C04]
Gender: Female, Male. Age: 0-17 years, 18-64 years, 65+ years. Enrolment: 2.
Status: Ended. Start date (EU): 2019-12-05. End date (EU): 2026-01-08. End date: 2026-02-28. Decision date: 2024-03-15. Results received: No. Last updated: 2025-08-06.
Decision dates by country: DE: 2024-03-15, ES: 2024-03-15

Condition(s): Advanced solid tumors (other than Urothelial tumors), and FGFR gene alterations.
Product: JNJ-42756493, JNJ-42756493, JNJ-42756493

Primary endpoint: For Broad Panel Cohort and Core Panel Cohort: The proportion of subjects who achieve a complete response (CR) or partial response (PR) based on Response Evaluation Criteria in Solid Tumors (RECIST, version 1.1) (RECIST v1.1.) or Response Assessment in Neuro-Oncology (RANO) as assessed by IRC., Pediatric Cohort: The proportion of subjects who achieve a CR or PR based on RECIST v1.1 or RANO as assessed by IRC

Source: https://euclinicaltrials.eu/ctis-public/view/2023-510301-18-00